EU clinical trial 2023-503909-11-01: Phase I, double-blind, randomized, placebo-controlled study investigating the safety, tolerability and concentrations of the study product KAND145 in healthy volunteers
Protocol code: KAN0008
Sponsor: Kancera AB (Pharmaceutical company). Phase: Human Pharmacology (Phase I)- First administration to humans. Countries: Finland (ended).
Therapeutic area(s): Diseases [C] - Neoplasms [C04]
Gender: Female, Male. Age: 18-64 years. Enrolment: 88.
Start date (EU): 2023-10-30. Decision date: 2023-10-20. Results received: No. Last updated: 2024-02-07.

Condition(s): Ovarian cancer

Source: https://euclinicaltrials.eu/ctis-public/view/2023-503909-11-01